EU clinical trial 2024-511430-12-00: Phase I study to evaluate the safety, tolerability and preliminary efficacy of the bispecific PSMAxCD3 antibody CC 1 in men with biochemical recurrence of prostate cancer
Protocol code: ProSperA_CC-1
Sponsor: Universitaetsklinikum Tuebingen AöR (Hospital/Clinic/Other health care facility). Phase: Human Pharmacology (Phase I)- First administration to humans. Countries: Germany (ongoing, recruiting).
Therapeutic area(s): Diseases [C] - Male Urogenital Diseases [C12]
Gender: Male. Age: 18-64 years, 65+ years. Enrolment: 56.
Status: Ongoing, recruiting. Start date (EU): 2022-11-11. Decision date: 2024-03-05. Results received: No. Last updated: 2026-04-09.

Condition(s): Prostate cancer recurrent

Source: https://euclinicaltrials.eu/ctis-public/view/2024-511430-12-00